EU clinical trial 2024-516967-10-00: The relationship of cholesterol-lowering drugs with steroid HORMONEs, bile acids, muscle morphology, vitamin D, the immune system and related diseases such as depression and osteoporosis
Protocol code: CHORMONE
Sponsor: Medical University Of Vienna (Educational Institution). Phase: Therapeutic use (Phase IV). Countries: Austria (ongoing, recruiting).
Therapeutic area(s): Diseases [C] - Cardiovascular Diseases [C14]
Gender: Female, Male. Age: 18-64 years, 65+ years. Enrolment: 250.
Status: Ongoing, recruiting. Start date (EU): 2024-12-10. Decision date: 2024-12-10. Results received: No. Last updated: 2024-12-10.

Condition(s): Hyperlipidemia
Product: ALIROCUMAB, ROSUVASTATIN, EVOLOCUMAB, ROSUVASTATIN, ATORVASTATIN, ATORVASTATIN, INCLISIRAN, ALIROCUMAB, ROSUVASTATIN, ATORVASTATIN, ATORVASTATIN, ATORVASTATIN, ROSUVASTATIN, Praluent 150 mg solution for injection in pre-filled pen, INCLISIRAN, Repatha 140 mg solution for injection in pre-filled syringe, ATORVASTATIN, ALIROCUMAB, Rosuvastatin 5 mg film-coated tablets, Leqvio 284 mg solution for injection in pre-filled syringe, ROSUVASTATIN, EVOLOCUMAB, Atorvastatin 10 mg film-coated tablets

Primary endpoint: Changes in sex steroid levels

Source: https://euclinicaltrials.eu/ctis-public/view/2024-516967-10-00